EU clinical trial 2024-518888-35-00: Neural Stem Cell Treatment for Amyotrophic Lateral Sclerosis: A multicenter, randomized placebo controlled and biological endpoints clinical Trial
Protocol code: STEMALS
Sponsor: Casa Sollievo Della Sofferenza (Hospital/Clinic/Other health care facility). Phase: Therapeutic exploratory (Phase II). Countries: Italy (ongoing, recruiting).
Therapeutic area(s): Diseases [C] - Pathological Conditions, Signs and Symptoms [C23]; Diseases [C] - Nervous System Diseases [C10]
Gender: Female, Male. Age: 18-64 years. Enrolment: 30.
Status: Ongoing, recruiting. Start date (EU): 2024-01-24. Decision date: 2024-11-18. Results received: No. Last updated: 2025-12-17.

Condition(s): amyotrophic lateral sclerosis patients
Product: SODIUM CHLORIDE

Primary endpoint: Incidence of adverse events directly related to the IMP, infusion site reactions, clinically relevant changes in neurologic function, laboratory values, and vital signs
Endpoint(s): To compare the change in slopes in points per month (≥0.5 to ≥2.5 for responders) from the pre-transplantation period to the post transplantation period in ALSFRS-R between the treatment and placebo groups through 3 months post first transplantation, To compare the change in slopes from the pre-transplantation period to the post transplantation period in FVC (≥25% to ≥100% change for responders) between the treatment and placebo groups through 3 months post first transplantation, To compare the slope of the rate of decline in the ALSFRS-R at 3 and 6 months following first transplantation relative to the 3-4 months baseline period before transplantation in all patients (both treatment and placebo groups)., To compare the slope of the rate of decline in FVC at 3 and 6 months following first transplantation relative to the 3-4 months baseline period before transplantation in all patients (both treatment and placebo groups)., To collect data on the impact of hNSC transplantation on quality of life as measured by ALSAQ-40 scale, To evaluate the biological activity of hNSC treatment by measuring the levels of selected pharmacodynamics biomarkers in CSF and serum. Data will be statistically assessed for significance by either Student t test or analysis of variance as applicable. A p value of less than 0.05 will be considered statistically significant. Candidate markers include: lNf, GFAP, NF1, VEGF, Osteopontin, CXCL13, Cystatina, MCP-1 BDNF, YKL-40, IL-6, TNF-a, IL-17, TDP43 TAU., In parallel to the clinical evaluation of hNSCs efficacy we will also develop patient-specific cell models in order to individuate molecular and cellular mechanisms supporting the putative therapeutic action of hNSCs treatment. These models will be derived from blood or skin cells of the patients recruited in the trial in order to produce iPS cells, then differentiated in NSCs.

Source: https://euclinicaltrials.eu/ctis-public/view/2024-518888-35-00